EU clinical trial 2024-510637-18-00: The effect of denosumab on muscle and strength and insulin sensitivity
Sponsor: Region Midtjylland (Hospital/Clinic/Other health care facility). Phase: Therapeutic use (Phase IV). Countries: Denmark (ongoing, recruiting).
Therapeutic area(s): Diseases [C] - Musculoskeletal Diseases [C05]; Diseases [C] - Hormonal diseases [C19]
Gender: Female. Age: 18-64 years. Enrolment: 40.
Status: Ongoing, recruiting. Start date (EU): 2024-05-21. Decision date: 2024-03-26. Results received: No. Last updated: 2026-05-20.

Condition(s): Postmenopausal osteoporosis, Diabetes Mellitus
Product: DENOSUMAB, SALINE

Primary endpoint: Changes in muscle mass and muscle strength from baseline to month 12., Changes in insulin sensitivity (Hb1Ac, HOMA-IR, fasting glucose, oral glucose tolerance test (OGTT)) from baseline to month 12.
Endpoint(s): Changes in DPP-4 and GLP-1 from baseline to month 12., Changes in carboxy-terminal collagen crosslinks (CTX) and procollagen type I N-terminal propeptide (PINP) from baseline to month 12., Change in lumbar spine BMD from baseline to month 12., Change in advanced glycation end products (AGEs) from baseline to month 12., Changes in muscle strength from baseline to month 1 and 3., Changes in insulin sensitivity (Hb1Ac, HOMA-IR, and fasting glucose) from baseline to month 1 and 3

Source: https://euclinicaltrials.eu/ctis-public/view/2024-510637-18-00